EU clinical trial 2024-520318-23-00: Phase I/II randomized clinical trial of selinexor plus gemcitabine in selected advanced soft-tissue sarcomas
Protocol code: SELNET-7-1(SeliSarc)
Sponsor: Asociacion Europea Y Latinoamericana SELNET Para La Investigacion En Sarcomas (Patient organisation/association). Phase: Phase I and Phase II (Integrated)- Other. Countries: Spain (authorised, recruitment pending).
Therapeutic area(s): Diseases [C] - Neoplasms [C04]
Gender: Female, Male. Age: 18-64 years, 65+ years. Enrolment: 88.
Status: Authorised, recruitment pending. Decision date: 2024-12-27. Results received: No. Last updated: 2026-06-25.

Condition(s): Patients with advanced soft-tissue sarcoma (leiomyosarcoma or malignant peripheral nerve sheath tumor) will receive selinexor in combination with gemcitabine.
Product: Gemcitabina Accord 200 mg concentrado para solución para perfusión, SELINEXOR

Primary endpoint: Phase I:Based on Dose Limiting Toxicities (DLTs) observed during first cycle (day 1-21)., Phase II: Progression-free survival rate (PFSR): Efficacy measured by the PFSR at 6 months according to RECIST 1.1. PFSR at 6 months is defined as the percentage of patients who did not experience progression or death due to any cause since the first dose of experimental treatment until month 6 after treatment initiation.
Endpoint(s): Phase I: Safety profile of the experimental treatment, through assessment of adverse event type,incidence, severity, time of appearance, related causes, as well as physical explorations and laboratory tests. Toxicity will be graded and tabulated by using CTCAE 5.0, Phase I: Overall Response Rate (ORR): ORR is defined as the number of subjects with a Best Overall Response (BOR) of Complete Response (CR) or Partial Response (PR) divided by the number of response evaluable subjects (according to RECIST 1.1 criteria)., Phase I:Efficacy measured through tumor response according to Choi criteria. The evaluation criteria will be based on the identification of target lesions in baseline and their follow-up until tumor progression., Phase I: Quality of life will be measured with EORTC QLQ-C30., Phase II: Overall survival (OS): OS is defined as the time between the date of first dose and the date of death due to any cause. OS will be censored on the last date a subject was known to be alive., Phase II: Overall Response Rate (ORR): ORR is defined as the number of subjects with a Best Overall Response (BOR) of Complete Response (CR) or Partial Response (PR) divided by the number of response evaluable subjects (according to RECIST 1.1 criteria)., Phase II: Efficacy measured through tumor response according to Choi criteria. The evaluation criteria will be based on the identification of target lesions in baseline and their follow-up until tumor progression., Phase II: Safety profile of the experimental treatment, through assessment of adverse event type, incidence, severity, time of appearance, related causes, as well as physical explorations and laboratory tests. Toxicity will be graded and tabulated by using CTCAE 5.0., Phase II:Clinical outcomes of post protocol treatments assessed by observation of such treatments in follow-up stage., Phase II:Quality of life will be measured with EORTC QLQ-C30.

Source: https://euclinicaltrials.eu/ctis-public/view/2024-520318-23-00